EU clinical trial 2025-521562-95-00: Randomised, Multicentre, Multinational, Double-Blind Integrated Study to Compare the Pharmacokinetics, Efficacy, Safety, and Immunogenicity of MB11 (Proposed Nivolumab Biosimilar) Versus EU-/US-Opdivo in Subjects With Previously Untreated Advanced (Unresectable or Metastatic) Melanoma (LEON Study)
Protocol code: MB11-C-01-25
Sponsor: Mabxience Research S.L. (Pharmaceutical company). Phase: Therapeutic confirmatory (Phase III). Countries: Italy (authorised, recruiting), Spain (ongoing, recruiting), Slovakia (authorised, recruiting), Romania (authorised, recruiting), Portugal (authorised, recruiting), Greece (authorised, recruiting), Poland (ended).
Therapeutic area(s): Diseases [C] - Musculoskeletal Diseases [C05]
Gender: Female, Male. Age: 18-64 years, 65+ years. Enrolment: 119.
Start date (EU): 2025-12-30. Decision date: 2025-11-18. Results received: No. Last updated: 2026-06-04.
Decision dates by country: IT: 2025-11-20, SK: 2025-11-18, GR: 2025-11-20, PL: 2025-11-21, PT: 2025-11-18, RO: 2025-11-24, ES: 2025-11-21

Condition(s): Previously Untreated Advanced (Unresectable or Metastatic) Melanoma
Product: OPDIVO 10 mg/mL concentrate for solution for infusion., OPDIVO 10 mg/mL concentrate for solution for infusion., US Opdivo

Primary endpoint: Co-Primary Endpoints: - PK: • AUC0-336 between Cycle 1 and Cycle 2 (for Estimand 1a) • AUCss, between Cycle 8 and Cycle 9 (for Estimand 1b) - Efficacy, assessed by a BICR per RECIST v1.1:, • bOR where a responder must have achieved CR or PR while alive, prior to permanent treatment discontinuation, prior to use of other anti-cancer therapies and by 24 weeks after Day 1 (for the FDA Primary Estimand 2a and EMA Primary Estimand 2b), Supportive efficacy endpoint (assessed by BICR per RECIST v 1.1): • Composite bOR where responder must be alive, able to remain on or resume treatment, and achieved CR or PR without use of other anti-cancer therapies up to 24 weeks after Day 1 (for Estimand 2c)
Endpoint(s): Secondary efficacy endpoints assessed by BICR at the following time points post Day 1: • Composite OR at 10, 16, 24, 32, and 52 weeks • PFS at 24 and 52 weeks • DOR • OS at 24 and 52 weeks PK endpoints, not covered by the primary endpoints: • Cmax in Cycle 1 and Cycle 8 • Ctrough: Cycle 1 to EOT visit as per the SoE, Safety endpoints include (52 weeks from baseline [Day 1] and up to EOS) • Incidence, nature and severity of TEAE, including SAEs, SUSARs and AESIs over the study period. • Other safety endpoints as follows: o Absolute values and changes from baseline in: o Clinical laboratory assessments (haematology, clinical chemistry [including selected hormone panel], coagulation and urinalysis)., o Vitals signs parameters (systolic and diastolic blood pressure, pulse rate, respiratory rate, and body temperature). o Incidence of abnormalities in: o Clinical laboratory parameters o 12-lead ECG o Physical examination, Immunogenicity endpoints over the study include (time frame: 52 weeks from baseline [Day 1] as per SoE): • ADAs • NAbs in ADA (+) samples • Titres in ADA (+) samples

Source: https://euclinicaltrials.eu/ctis-public/view/2025-521562-95-00